EU clinical trial 2024-511901-52-00: Pembrolizumab and olaparib in recurrent/metastatic, platinum resistant nasopharyngeal cancer. POINT study
Protocol code: POINT
Sponsor: Fondazione GONO Plus (Laboratory/Research/Testing facility). Phase: Therapeutic exploratory (Phase II). Countries: Italy (ongoing, recruitment ended).
Therapeutic area(s): Diseases [C] - Neoplasms [C04]
Gender: Female, Male. Age: 18-64 years, 65+ years. Enrolment: 30.
Status: Ongoing, recruitment ended. Start date (EU): 2022-03-24. Decision date: 2024-10-16. Results received: No. Last updated: 2026-04-16.

Condition(s): Adult patients affected by recurrent/metastatic, platinum resistant nasopharyngeal cancer
Product: KEYTRUDA 25 mg/mL concentrate for solution for infusion, Olaparib, Olaparib

Primary endpoint: Objective Response Rate (ORR) as Assessed by Investigators according to Response Evaluation Criteria in Solid Tumors Version 1.1 by the 3rd radiological examination (week 27). ORR is defined as the percentage of participants who have a Complete Response (CR: Disappearance of all target lesions) or a Partial Response (PR: At least a 30% decrease in the sum of diameters of target lesions) per RECIST 1.1.
Endpoint(s): Rate of patients with adverse events grade >= 3 and all grade adverse events classified according to the CTCAE v5.0, Progression-Free Survival (PFS) PFS is defined as the time from first dose to the first documented progressive disease (PD) per RECIST 1.1 or death due to any cause, whichever occurs first. Per RECIST 1.1, PD is defined as ≥20% increase in the sum of diameters of target lesions. In addition to the relative increase of 20%, the sum must also demonstrate an absolute increase of ≥5 mm. The appearance of one or more lesions is also considered PD., Overall Survival (OS) OS is the time from first dose to death due to any cause. Patients alive or lost to follow-up are censored. Follow-up will continue at most 3 years since last patient first visit., Change in the Quality-of-Life (QoL) since Baseline Using the European Organization for Research and Treatment of Cancer Quality of Life Questionnaire Head and Neck Module (EORTC QLQ-HN43)

Source: https://euclinicaltrials.eu/ctis-public/view/2024-511901-52-00